EU clinical trial 2024-515658-26-00: A Phase 3, Multicenter, Randomized, Open-label Trial of Trastuzumab Deruxtecan in Combination with Pembrolizumab Versus Platinum-based Chemotherapy in Combination with Pembrolizumab, as First-line Therapy in Participants with Locally Advanced Unresectable or Metastatic HER2-overexpressing and PD-L1 TPS <50% Non-squamous Non-small Cell Lung Cancer. (DESTINY-Lung06)
Protocol code: DS8201-793
Sponsor: Daiichi Sankyo Inc. (Pharmaceutical company). Phase: Therapeutic confirmatory (Phase III). Countries: France (ongoing, recruiting), Belgium (ongoing, recruiting), Germany (authorised, recruitment pending), Portugal (ongoing, recruiting), Italy (ongoing, recruiting), Greece (ongoing, recruiting), Romania (ongoing, recruiting), Spain (ongoing, recruiting), Poland (ended).
Therapeutic area(s): Diseases [C] - Neoplasms [C04]
Gender: Female, Male. Age: 18-64 years, 65+ years. Enrolment: 159.
Start date (EU): 2026-01-21. Decision date: 2025-10-06. Results received: No. Last updated: 2026-05-11.
Decision dates by country: FR: 2025-10-10, GR: 2025-11-13, BE: 2025-10-15, PL: 2025-10-10, RO: 2025-10-15, DE: 2025-10-09, PT: 2025-10-06, ES: 2025-10-10, IT: 2025-10-06

Condition(s): Unresectable or Metastatic HER2 overexpressing and PD-L1 TPS <50% Non-squamous Non-small Cell Lung Cancer
Product: CARBOPLATIN, CARBOPLATIN, DS-8201a, PEMETREXED, CISPLATIN, PEMBROLIZUMAB

Primary endpoint: Progression-free survival (PFS) by BICR. PFS is defined as the time interval from the date of randomization to the date of radiographic disease progression or death due to any cause. Tumor response will be determined by BICR assessment of tumor scans using RECIST v1.1.
Endpoint(s): Overall Survival (OS). OS is defined as the time interval from the date of randomization to the date of death due to any cause.

Source: https://euclinicaltrials.eu/ctis-public/view/2024-515658-26-00